EU clinical trial 2022-502878-16-00: Safety and Efficacy of intra-arterial Tenecteplase for non-complete reperfusion of intracranial occlusion
Sponsor: Insel Gruppe AG (Hospital/Clinic/Other health care facility). Phase: Therapeutic confirmatory (Phase III). Countries: Finland (ended), Austria (ended), Belgium (ended), Germany (ended), Portugal (ended), Netherlands (ended).
Therapeutic area(s): Not possible to specify
Gender: Female, Male. Age: 18-64 years, 65+ years. Enrolment: 140.
Status: Ended. Start date (EU): 2025-01-23. End date (EU): 2026-01-14. End date: 2026-01-15. Decision date: 2023-07-12. Results received: No. Last updated: 2026-05-19.
Decision dates by country: FI: 2023-07-12, AT: 2024-09-09, PT: 2025-03-31, BE: 2024-08-30, NL: 2025-05-16, DE: 2024-08-26

Condition(s): Acute ischemic strokes with incomplete reperfusion
Product: Metalyse 10,000 units. Powder and solvent for solution for injection

Primary endpoint: Early and late reperfusion
Endpoint(s): Degree of disability or dependence at 90+/-15 days as assessed by the mRS (shift analysis), Normalized change in NIHSS at 24+/- 6h post-randomization., Change in NIHSS at 90+/- 15 days post-randomization., Quality of life as assessed by the EuroQol 5D-3L at 90+/- 15 days, All-cause mortality at 90 days, No significant disability (i.e. mRS 0-1) at 90+/-15 days

Source: https://euclinicaltrials.eu/ctis-public/view/2022-502878-16-00